EU clinical trial 2025-521792-31-01: Phase 3 Study to Evaluate the Efficacy and Safety of Zodasiran in Adolescent and Adult Subjects with Homozygous Familial Hypercholesterolemia (YOSEMITE)
Protocol code: AROANG3-3001
Sponsor: Arrowhead Pharmaceuticals Inc. (Pharmaceutical company). Phase: Therapeutic confirmatory (Phase III). Countries: Greece (ended), France (ongoing, recruitment ended), Belgium (ongoing, recruitment ended), Germany (ongoing, recruitment ended), Netherlands (ended), Austria (ongoing, recruitment ended), Sweden (ongoing, recruitment ended), Spain (ongoing, recruitment ended), Czechia (ongoing, recruitment ended), Italy (ended).
Therapeutic area(s): Diseases [C] - Cardiovascular Diseases [C14]
Gender: Female, Male. Age: 0-17 years, 18-64 years, 65+ years. Enrolment: 18.
Start date (EU): 2026-04-07. Decision date: 2026-01-23. Results received: No. Last updated: 2026-05-21.
Decision dates by country: NL: 2026-01-28, FR: 2026-01-28, ES: 2026-01-28, CZ: 2026-01-23, GR: 2026-01-26, SE: 2026-01-23, AT: 2026-01-26, IT: 2026-01-23, DE: 2026-01-26, BE: 2026-01-23

Condition(s): Homozygous Familial Hypercholesterolemia (HoFH)
Product: Placebo of Zodasiran, ARO-ANG3

Primary endpoint: Percent Change from Baseline to Month 12 in Fasting Low Density Lipoprotein Cholesterol (LDL-C) (Randomized period)
Endpoint(s): 1. Percent Change from Baseline to Month 12 in Fasting Apolipoprotein B (ApoB) (Randomized Period), 2. Percent Change from Baseline to Month 12 in Fasting Non-High Density Lipoprotein Cholesterol (non-HDL-C) (Randomized Period), 3. Change from Baseline to Month 12 in Fasting LDL-C (Randomized Period), 4. Area Under the Plasma Concentration Versus the Time Curve (AUC) from Baseline to Month 12 for Fasting LDL-C (Randomized Period), 5. Percent Change from Baseline to Month 12 in Fasting Triglycerides (TGs) (Randomized Period), 6. Percent Change from Baseline to Month 12 in Fasting Angiopoietin-like Protein 3 (ANGPTL3) (Randomized Period), 7. Percent Change from Baseline to Month 12 in Fasting Total Cholesterol (Randomized Period), 8. Percent Change from Baseline to Month 12 in Fasting High-Density Lipoprotein Cholesterol (HDL-C) (Randomized Period), 9. Proportion of Participants who Meet European Union (EU) LDL-C Apheresis Eligibility Criteria (per German Apheresis Working Group) at Month 12 (Randomized Period), 10. Proportion of Participants who Meet United States (US) Apheresis Eligibility Criteria (per National Lipid Association) at Month 12 (Randomized Period), 11. Proportion of Participants with Fasting LDL-C <100 mg/dL (2.6 mmol/L) at Month 12 (Randomized Period), 12. Change from Baseline in Fasting LDL-C Over Time (Randomized Period), 13. Percent Change from Baseline in fasting LDL-C Over Time (Randomized Period), 14. Percent Change from Baseline to Month 12 in Fasting Lipoprotein(a) [Lp(a)] (Randomized Period)

Source: https://euclinicaltrials.eu/ctis-public/view/2025-521792-31-01